EU clinical trial 2023-504477-21-01: A prospective, observer-blind, randomized clinical trial to investigate and compare the clinical efficacy of Chloroprocaine 3% gel and Oxybuprocaine 0.4% eye drops anesthesia for clinical practice in pediatric population.
Protocol code: CHL.3-01-2021-M
Sponsor: Sintetica S.A. (Pharmaceutical company). Phase: Therapeutic confirmatory (Phase III). Countries: Italy (ended).
Therapeutic area(s): Diseases [C] - Eye Diseases [C11]
Gender: Female, Male. Age: 0-17 years. Enrolment: 74.
Status: Ended. Start date (EU): 2024-05-14. End date (EU): 2025-03-13. Decision date: 2024-03-25. Results received: Yes. Last updated: 2024-12-13.

Condition(s): male/female outpatients, aged 0-17 years scheduled to undergo ocular exams with a need of ocular surface anesthesia.
Product: Chloroprocaine Hydrochloride 30 mg/g eye gel, OXYBUPROCAINE

Primary endpoint: Primary endpoint will be to assess the proportion of patients in each treatment group with a successful conjunctiva anesthesia in the right eye, 5 minutes after study product administration, i.e. right before the ocular examination, to be assessed by eye spear sponge.
Endpoint(s): Safety endpoints: - Objective ocular signs (palpebral edema, chemosis, conjunctival hyperemia, conjunctival discharge, follico-papillary conjunctivitis, corneal staining punctuations, anterior chamber cells, flare) and other objective ocular signs, assessed by slit lamp examination (SLE) or binocular indirect ophthalmoscopy (BIO), will be graded according to the following scale: 0=none, 1=mild, 2=moderate, 3=severe., Safety endpoint: Adverse events occurrence throughout the study, Safety endpoints: Product global tolerance will be graded by the Investigator by answering the following question “How do you consider the study product global tolerance” using the following scale: 0=very unsatisfactory, 1=unsatisfactory, 2= satisfactory, 3=very satisfactory.

Source: https://euclinicaltrials.eu/ctis-public/view/2023-504477-21-01